EU clinical trial 2024-519405-35-00: NEurotrophins Mimetic compound for the treatment of diabetic foot UlcerS
Sponsor: Mimetech S.r.l. (Pharmaceutical company). Phase: Phase I and Phase II (Integrated)- First administration to humans. Countries: Italy (authorised, recruitment pending).
Therapeutic area(s): Diseases [C] - Skin and Connective Tissue Diseases [C17]
Gender: Female, Male. Age: 18-64 years, 65+ years. Enrolment: 24.
Status: Authorised, recruitment pending. Decision date: 2025-01-13. Results received: No. Last updated: 2025-09-25.

Condition(s): Diabetic Foot Ulcer
Product: Udonitrectag

Primary endpoint: Safety and tolerability: I. Nature, frequency, severity, and timing of adverse events including skin irritation, haematological, hepatic, and renal events, II. Clinical laboratory results during and following udonitrectag administration, III. Pharmacokinetics
Endpoint(s): Efficacy: percentage (number) of patients with ulcer achieving an area reduction of at least 50% from baseline during 6-week treatment. The percentage change area is defined as ((Area0 - Areat)/Area0)*100.

Source: https://euclinicaltrials.eu/ctis-public/view/2024-519405-35-00